EU clinical trial 2023-505299-31-00: A Phase I study to evaluate the pharmacokinetics, safety, and tolerability of multiple oral doses of obefazimod in patients with mild and moderate hepatic impairment, compared to matched control groups.
Protocol code: ABX464-908
Sponsor: Abivax (Pharmaceutical company). Phase: Human Pharmacology (Phase I)- Other. Countries: Germany (ended).
Therapeutic area(s): Diseases [C] - Immune System Diseases [C20]
Gender: Female, Male. Age: 18-64 years, 65+ years. Enrolment: 32.
Status: Ended. Start date (EU): 2023-10-09. End date (EU): 2024-09-11. Decision date: 2023-09-11. Results received: No. Last updated: 2024-04-30.

Condition(s): Ulcerative colitis and rheumatoid a1thritis

Source: https://euclinicaltrials.eu/ctis-public/view/2023-505299-31-00